EU clinical trial 2024-515078-28-00: A phase 1, open-label trial in healthy subjects and in subjects with diabetes investigating pharmacokinetics, tolerability, safety, and food effect following single and multiple dosing of danegaptide
Protocol code: C24-1006
Sponsor: Breye Therapeutics ApS (Pharmaceutical company). Phase: Human Pharmacology (Phase I)- Other. Countries: Sweden (ended).
Therapeutic area(s): Diseases [C] - Eye Diseases [C11]; Diseases [C] - Nutritional and Metabolic Diseases [C18]
Gender: Female, Male. Age: 18-64 years, 65+ years. Enrolment: 56.
Status: Ended. Start date (EU): 2025-04-16. End date (EU): 2025-10-27. Decision date: 2025-03-14. Results received: No. Last updated: 2025-08-11.

Condition(s): Diabetic Retinopathy

Source: https://euclinicaltrials.eu/ctis-public/view/2024-515078-28-00